EU clinical trial 2024-514702-31-00: Daratumumab in combination with Carfilzomib, Pomalidomide and Dexamethasone (DCPD) in patients with multiple myeloma induced acute renal failure - "Time is Kidney in the Treatment of myeloma Cast nephropathy" The TIKTAC phase II trial (Pilot-study)
Protocol code: TIKTAC
Sponsor: Medizinische Universitaet Innsbruck (Educational Institution). Phase: Therapeutic exploratory (Phase II). Countries: Austria (authorised, recruitment pending).
Therapeutic area(s): Diseases [C] - Hemic and Lymphatic Diseases [C15]
Gender: Female, Male. Age: 18-64 years, 65+ years. Enrolment: 50.
Status: Authorised, recruitment pending. Decision date: 2024-10-29. Results received: No. Last updated: 2024-10-29.

Condition(s): Multiple myeloma
Product: DARZALEX 20 mg/mL concentrate for solution for infusion, Kyprolis 60 mg powder for solution for infusion, Fortecortin 4 mg Tabletten, Imnovid 1 mg hard capsules, Imnovid 3 mg hard capsules, Fortecortin 8 mg Tabletten, Imnovid 4 mg hard capsules, Imnovid 2 mg hard capsules, Kyprolis 30 mg powder for solution for infusion, Kyprolis 10 mg powder for solution for infusion

Primary endpoint: Dialysis dependent patients: To determine the rate of patients becoming dialysis independent after induction treatment in patients with myeloma induced renal failure requiring dialysis and receiving induction treatment with 4 cycles of daratumumab in combination with carfilzomib, pomalidomide and dexamethasone (DCPD), Patients not dialysis dependent: To determine the rate of patients achieving improvement of their renal function after induction treatment. Patients receive induction treatment with 4 cycles of daratumumab in combination with carfilzomib, pomalidomide and dexamethasone (DCPD)renal recovery
Endpoint(s): Progression free survival at 1 year (PFS)in months, defined as the time from day 1 of cycle 1 to the date of first documentation of disease progression based on IMWG criteria or death due to any cause, whichever occurs first., Overall response rate (ORR) being described as complete response, near complete response, very good partial response, partial response, minor response, stable disease, progressive disease. ORR will be assessed according to International Myeloma Working Group (IMWG) criteria, including Minor Response (MR) according to European Society for Blood and Bone Marrow Transplantation (EBMT) criteria, Time to first response defined as days from day 1 of cycle 1 to the first documented response, Time to best response defined (days) from day 1 of cycle 1 to the best documented response, Recording of AE´s, SAE´s, ECOG performance status, assessment of clinical laboratory values., Minimal residual disease will be performed in bone marrow samples (only in patients achieving complete response after cycle 4) according to the Euroflow-protocol (FACS-Analysis) with a sensitivity of 10-5)

Source: https://euclinicaltrials.eu/ctis-public/view/2024-514702-31-00